EU clinical trial 2024-514394-22-00: A Phase 4, Multi-centre, Randomized, Evaluator-blinded, Active-controlled Study to Determine the Incidence of Squamous Cell Carcinoma and Evaluate the Long-term Safety of Tirbanibulin 10 mg/g Ointment and Diclofenac Sodium 3% Gel for the Treatment of Adult Patients With Actinic Keratosis on the Face or Scalp
Protocol code: M-14789-41
Sponsor: Almirall S.A. (Pharmaceutical company). Phase: Therapeutic use (Phase IV). Countries: Germany (ongoing, recruitment ended), Italy (ongoing, recruitment ended), Spain (ongoing, recruitment ended), France (ongoing, recruitment ended), Poland (ongoing, recruitment ended).
Therapeutic area(s): Diseases [C] - Skin and Connective Tissue Diseases [C17]
Gender: Female, Male. Age: 18-64 years, 65+ years. Enrolment: 418.
Status: Ongoing, recruitment ended. Start date (EU): 2022-10-24. Decision date: 2024-07-15. Results received: No. Last updated: 2026-07-13.
Decision dates by country: FR: 2024-08-12, DE: 2024-07-22, ES: 2024-07-15, PL: 2024-08-04, IT: 2024-07-23

Condition(s): Actinic Keratosis
Product: Solaraze 30 mg/g Gel, Klisyri 10 mg/g ointment

Primary endpoint: Proportion of patients with histologically confirmed invasive SCC in the TF over the 3-year study period.
Endpoint(s): AEs and SAEs over 3 years, Proportion of patients with any other skin cancer (other than SCC) in the TF over the 3-year study period, Time to occurrence of invasive SCC from baseline in the TF., Proportion of patients requiring rescue treatment after 1 treatment course., Proportion of patients requiring rescue treatment at any time during the study., Proportion of patients with no lesions after treatment of the first recurrence with tirbanibulin during the first 52 weeks., Other safety assessments (vital signs, PE) over 3 years., Change from baseline in Skindex-16 overall and for all three domain scores (Symptoms, Emotions, and Functioning) by arm and by visit., Cosmetic outcome by arm and by visit., Treatment Satisfaction Questionnaire for Medication transformed scores by arm and by visit.

Source: https://euclinicaltrials.eu/ctis-public/view/2024-514394-22-00